EU clinical trial 2023-505575-69-01: Fight Osteosarcoma Through European Research evolving study platform from diagnosis to relapse (FOSTER evolving study platform)
Protocol code: 2025/4106
Sponsor: Institut Gustave Roussy (Hospital/Clinic/Other health care facility). Phase: Therapeutic confirmatory (Phase III). Countries: Sweden (authorised, recruitment pending), Poland (authorised, recruitment pending), Denmark (authorised, recruitment pending), Finland (authorised, recruitment pending), Netherlands (authorised, recruitment pending), Italy (authorised, recruitment pending), France (authorised, recruiting), Spain (authorised, recruitment pending).
Therapeutic area(s): Diseases [C] - Neoplasms [C04]
Gender: Female, Male. Age: 0-17 years, 18-64 years, 65+ years. Enrolment: 508.
Start date (EU): 2026-07-31. Decision date: 2026-07-08. Results received: No. Last updated: 2026-07-13.
Decision dates by country: NL: 2026-07-10, ES: 2026-07-10, FR: 2026-07-10, PL: 2026-07-13, DK: 2026-07-08, SE: 2026-07-08, FI: 2026-07-08, IT: 2026-07-08

Condition(s): Osteosarcoma
Product: CABOMETYX 60 mg film-coated tablets, CABOMETYX 20 mg film-coated tablets, CABOMETYX 40 mg film-coated tablets

Primary endpoint: For FOSTER evolving study platform: EFS: time from diagnosis to the first occurrence of progression/relapse (local, regional, or distant), second primary malignancy, or death from any cause; events per investigator assessment with central review when available. Patients without an event are censored at the date of last follow-up. The 3-year EFS rate will be estimated using Kaplan–Meier methods., For FOSTER-CabOS (first randomization) : Event-free survival (EFS): time from randomisation to first recurrence or progression (local, regional or distant) based on central review evaluation, or death from any cause. A patient without an event is considered censored at his or her last follow-up date.
Endpoint(s): For FOSTER evolving study platform : Feasibility and compliance: screening-to-enrolment rate, consent rate, time to enrolment/treatment start, CRF data completeness (baseline/induction), first line chemotherapy treatment delivery (dose intensity, delays, reductions, early discontinuation, reasons), adherence to scheduled follow-up visits., For FOSTER evolving study platform : Disease-free patient: A patient who remains disease-free and alive at the completion of the first line conventional chemotherapy, as determined by clinical and radiological assessments conducted between 6 and 10 months after the start of treatment., For FOSTER evolving study platform : Overall survival (OS): time from diagnosis to death from any cause, For FOSTER evolving study platform : EFS: time from diagnosis to the first occurrence of progression/relapse (local, regional, or distant), second primary malignancy, or death from any cause; events per investigator assessment with central review when available. Patients without an event are censored at the date of last follow-up., For FOSTER evolving study platform : Adverse events: incidence of treatment-emergent adverse events (AEs), serious adverse events (SAEs), and treatment-related mortality during induction., For FOSTER evolving study platform : Quality of life and functional outcome: QoL assessed by EORTC QLQ-C30 and PedsQL; functional outcome assessed by TESS at predefined timepoints., For FOSTER evolving study platform : Prognostic factors: association of clinical and biological variables (including G1/G2 signature at diagnosis) with OS and EFS via multivariable-adjusted Cox models. Results reported as hazard ratios (HRs) with 95% confidence intervals (CIs) (pre-specified covariates and handling of missing data per SAP)., For FOSTER-CabOS (first randomization) : Adverse events (AE), a real-time reporting of any AE of grade 3+ is planned during the first 8 weeks in the first 20 patients receiving mifamurtide., For FOSTER-CabOS (first randomization) : Quality-adjusted time without symptoms of disease or toxicity (Quality-adjusted Time Without Symptoms of disease recurrence or Toxicity (Q-TWiST)) computed from survival times (OS and Event Free Survival (EFS) duration) and adverse events data (duration of time spent with a severe-AE before progression/recurrence), For FOSTER-CabOS (first randomization) : Disease status based on initial staging and complete remission after first line treatment histological response; biological subgroups in particular G1/G2 diagnostic RNAseq signature; type of first line chemotherapy; use of mifamurtide ; age, metastatic status at diagnosis., For FOSTER-CabOS (first randomization) : Heigh and growth plate, For FOSTER-CabOS (first randomization) : Description of would healing complication, For FOSTER evolving study platform : (if applicable) Comparisons between treatment sequences: comparisons of survival overall treatment sequences using Cox proportional hazards models (with multivariable adjustment) and Kaplan–Meier estimates with log-rank tests. The absence of randomization may also imply the use of weighting methods such as Inverse Probability of Censoring Weighting ( IPCW)., For FOSTER evolving study platform : ctDNA analyses., For FOSTER evolving study platform : Radiomics analyses., For FOSTER evolving study platform : Imaging-based definition of lung metastases (number, characteristics, location) derived by AI and compared with anatomic pathology., For FOSTER evolving study platform : Incorporation of questionnaire results into clinical interpretation., For FOSTER evolving study platform : Number of countries participating in the FOSTER-Evolving study platform over time., For FOSTER evolving study platform : Number of samples collected per registered patient., For FOSTER evolving study platform : Number and type of analyses performed per registered patient., For FOSTER evolving study platform : Number and type of imaging studies centralized in the imaging repository per registered patient, For FOSTER evolving study platform : Growth plate maturation through bone age, For FOSTER-CabOS (first randomization) : Group comparison on EFS and OS (OS being defined as the time from randomisation to death from any cause. The observation will be censored at the date of last follow-up in patients alive and free of event) « Cabozantinib vs BSC » - According to G1/G2 group - According to ctDNA content at daignosis - According to composition of the TME and cancer cells in the diagnosis biopsy, For FOSTER-CabOS (first randomization) : Growth plate maturation through bone age, For FOSTER-CabOS (first randomization) : Thickness of the growth plate, For FOSTER-CabOS (first randomization) : IGF1 value

Source: https://euclinicaltrials.eu/ctis-public/view/2023-505575-69-01